EU clinical trial 2024-519499-22-00: A Study to Evaluate ALN-BCAT in Patients With Hepatocellular Carcinoma
Sponsor: Alnylam Pharmaceuticals Inc. (Pharmaceutical company). Phase: Human Pharmacology (Phase I)- First administration to humans. Countries: Italy (ongoing, recruiting).
Therapeutic area(s): Diseases [C] - Neoplasms [C04]
Gender: Female, Male. Age: 18-64 years, 65+ years. Enrolment: 31.
Status: Ongoing, recruiting. Start date (EU): 2025-08-04. Decision date: 2025-06-27. Results received: No. Last updated: 2026-08-04.

Condition(s): Advanced or Metastatic Hepatocellular Carcinoma

Source: https://euclinicaltrials.eu/ctis-public/view/2024-519499-22-00